EU clinical trial 2023-507372-42-00: "A double blind, randomized, placebo-controlled, adaptive 24-week Phase II trial to evaluate the efficacy of vafidemstat in negative symptoms and cognitive impairment associated with schizophrenia" (EVOLUTION STUDY)
Protocol code: CL09-ORY-2001
Sponsor: Oryzon Genomics S.A. (Pharmaceutical company). Phase: Therapeutic exploratory (Phase II). Countries: Spain (ongoing, recruiting), Bulgaria (ongoing, recruiting), Romania (authorised, recruiting), Poland (authorised, recruitment pending), Slovakia (authorised, recruitment pending).
Therapeutic area(s): Psychiatry and Psychology [F] - Mental Disorders [F03]
Gender: Female, Male. Age: 18-64 years. Enrolment: 239.
Start date (EU): 2021-09-20. Decision date: 2024-10-18. Results received: No. Last updated: 2026-05-29.
Decision dates by country: ES: 2024-10-18, BG: 2026-04-27, RO: 2026-04-27, PL: 2026-04-29, SK: 2026-04-28

Condition(s): Schizophrenia
Product: Placebo capsules will be supplied as Swedish orange colored size 3 capsules that look identical to the vafidemstat capsules but contain no drug substance.

Primary endpoint: Efficacy: •To evaluate the change on the PANSS Factor Score for Negative Symptoms (PANSS-FSNS), from baseline to week 24, between the active treatment arm and the placebo arm.
Endpoint(s): Efficacy: To evaluate the change from baseline to week 24 on the Brief Assessment in Cognition in Schizophrenia (BACS), To evaluate the change over time on the PANSS Factor Score for Negative Symptoms (FSNS), To evaluate the change over time on the BACS, To evaluate the difference from baseline to week 24, as well as change over time on the following: a)PANSS Positive Symptoms Subscale (PANSS-PSS) b)PANSS Total Score c)Clinical Global Impression – Severity (CGI-S) for Schizophrenia d)Personal and Social Performance Scale (PSP) ..., To evaluate at every study visit, from baseline to week 24, as well as change over time, on the following: a) Number of visits to Health Care services (mental health emergency care services and hospitalizations) b) Changes in the stable background therapy from Screening visit, including the change to a new atypical antipsychotic treatment, the addition of a second atypical antipsychotic treatment to the background therapy, or the initiation of any medication for their schizophrenia or ...., Safety:To evaluate the following safety endpoints throughout the study, from baseline to week 28: a)Number, frequency, and severity of Treatment Emergent Adverse Events (TEAEs) b)Number, frequency, and severity of Serious TEAEs c)Number and percentage of withdrawn participants due to TEAEs d)Use of concomitant medications e)Frequency of physical examination parameters, vital signs...

Source: https://euclinicaltrials.eu/ctis-public/view/2023-507372-42-00